EU clinical trial 2024-518623-30-00: RAndomized, open label, multicenter study of Docetaxel versus an Androgen Receptor-targeted agent (abiraterone orenzalutamide) as first-line of therapy in mCRPC patients with adverse prognostic factors (RADAR-1 CRPC)
Protocol code: RADAR-1 CRPC
Sponsor: Fondazione Policlinico Universitario Agostino Gemelli IRCCS (Hospital/Clinic/Other health care facility). Phase: Therapeutic use (Phase IV). Countries: Italy (ongoing, recruiting).
Therapeutic area(s): Diseases [C] - Neoplasms [C04]
Gender: Male. Age: 18-64 years, 65+ years. Enrolment: 68.
Status: Ongoing, recruiting. Start date (EU): 2020-10-01. Decision date: 2024-11-26. Results received: No. Last updated: 2024-11-26.

Condition(s): metastatic castration resistant prostate cancer without mutations of BRCA1/2 genes or unknown
Product: ENZALUTAMIDE, DOCETAXEL, ABIRATERONE

Primary endpoint: To compare the radiographic Progression-Free Survival (rPFS) rate at 9 months of chemotherapy (Arm A, docetaxel plus prednisone) versus androgen receptor targeted therapy (Arm B, enzalutamide or abiraterone acetate plus prednisone) in mCRPC BRCA negative or unknown patients with adverse prognostic factors
Endpoint(s): To compare efficacy of docetaxel plus prednisone to enzalutamide or abiraterone acetate plus prednisone for: - PSA response rate; - Median rPFS; - Overall survival, To compare the safety of each treatment amog docetaxel abiraterone end enzalutamide, To compare Health-Related Quality Of Life (HRQOL) according to FACT-P questionnaire and Health status/utility (EQ-5D-5L) test

Source: https://euclinicaltrials.eu/ctis-public/view/2024-518623-30-00